EU clinical trial 2023-510241-16-00: A Phase 2, prospective, multi-center intervention trial in patients with acute myeloid leukemia secondary to myeloproliferative neoplasms unfit for intensive chemotherapy investigating a treatment combination including decitabine and venetoclax. ENABLE (vENetoclax plus decitAbine treatment in Blastic phase of myeLoproliferative nEoplasms). AML2420
Protocol code: AML2420
Sponsor: Fondazione Gimema Franco Mandelli Onlus (Health care). Phase: Therapeutic exploratory (Phase II). Countries: Italy (ongoing, recruitment ended).
Therapeutic area(s): Diseases [C] - Hemic and Lymphatic Diseases [C15]
Gender: Female, Male. Age: 18-64 years, 65+ years. Enrolment: 101.
Status: Ongoing, recruitment ended. Start date (EU): 2021-12-03. Decision date: 2024-07-08. Results received: No. Last updated: 2026-04-27.

Condition(s): Acute Myeloid Leukemia secondary to myeloproliferative neoplasms
Product: Dacogen 50 mg powder for concentrate for solution for infusion., Venclyxto 50 mg film-coated tablets, Venclyxto 100 mg film-coated tablets, Venclyxto 10 mg film-coated tablets

Primary endpoint: The primary endpoint is to evaluate the event free survival (EFS) at 1 year of an experimental VEN-DEC combination arm in patients with AML secondary to MPN and unfit for intensive therapeutic strategy. EFS is defined as the time between the date of treatment start and the date of either primary refractory disease (no achievement of at least ALR-C after 2 courses of treatment), first relapse (in patients who reached ALR-C) or death (whatever the cause), whichever occurs first.
Endpoint(s): Feasibility and safety of VEN-DEC regimen, as assessed by: 1. Adverse events rate as per v5.0 CTCAE criteria 2. Rate of deaths in aplasia as per ELN 2017 definition 3. Days to neutrophils recovery after first and second cycle in responding patients 4. Days to platelets recovery after first and second cycle in responding patients, Efficacy of VEN-DEC regimen, as assessed by: 1. Response rate categorized as at least Acute leukemia response-complete at first time-point after first cycle (ALR-C-T1) 2. Overall response rate at first time-point after first cycle categorized as ALR-C-T1 + ALR-P-T1 as per post-MPN AML consortium definition 3. Response rate categorized as at least ALR-C at secondo time-point after second cycle (ALR-C-T2), Efficacy of VEN-DEC regimen, as assessed by: 4. Overall response rate after second cycle categorized as ALR-C-T2 + ALR-P-T2 as per post-MPN AML consortium definition 5. Disease-free survival (DFS) as per ELN 2017 definition 6. Overall survival (OS) as per ELN 2017 definition 7. Cumulative incidence of relapse (CIR), Efficacy of VEN-DEC regimen, as assessed by: 8. Treatment-related mortality (TRM) 9. Transfusion need as defined as number of RBC and platelet units transfused over a period of 3 and 6 months of treatment as per institutional thresholds for transfusion support in hematological neoplasms.

Source: https://euclinicaltrials.eu/ctis-public/view/2023-510241-16-00